EU clinical trial 2023-508913-18-00: Transfer of prednisolone into human breast milk and plasma of breastfeeding children - A low intervention cohort study with biobanking of breast milk and plasma
Sponsor: Uppsala Universitet (Educational Institution). Phase: Therapeutic use (Phase IV). Countries: Sweden (ended).
Therapeutic area(s): Diseases [C] - Immune System Diseases [C20]
Gender: Female. Age: 18-64 years. Enrolment: 30.
Status: Ended. Start date (EU): 2024-03-05. End date (EU): 2025-12-31. Decision date: 2024-03-05. Results received: No. Last updated: 2024-11-15.

Condition(s): Reumatoid Arthritis, SLE, myositis, psoriatric arthritis, inflammatory bowel disease
Product: PREDNISOLONE

Primary endpoint: The primary endpoint is the concentration of prednisolone in the breastfeeding child’s plasma 2 hr after feeding an infant breast milk, with the feeding taking place at 1 hr following maternal dose intake.
Endpoint(s): Concentration of prednisolone and prednisone in breast milk at 1h after maternal dose intake and the maternal plasma concentration of prednisolone and prednisone at 1h after prednisolone intake., Concentration of cortisol in the infant blood at same timepoint blood is drawn for PK measurement.

Source: https://euclinicaltrials.eu/ctis-public/view/2023-508913-18-00